EU clinical trial 2025-524795-35-00: Phase IV study evaluating the efficacy and safety of the venetoclax + rituximab (VR) regimen in patients with relapsed chronic lymphocytic leukemia in Polish clinical practice
Protocol code: 2023/ABM/01/00072
Sponsor: Uniwersytet Medyczny W Lublinie (Educational Institution). Phase: Therapeutic use (Phase IV). Countries: Poland (authorised, recruitment pending).
Therapeutic area(s): Diseases [C] - Hemic and Lymphatic Diseases [C15]; Diseases [C] - Neoplasms [C04]
Gender: Female, Male. Age: 18-64 years, 65+ years. Enrolment: 36.
Status: Authorised, recruitment pending. Decision date: 2026-06-26. Results received: No. Last updated: 2026-06-26.

Condition(s): Adult with chronic lymphocytic leukemia/small lymphocytic lymphoma (CLL)
Product: MabThera 100 mg concentrate for solution for infusion, Venclyxto 50 mg film-coated tablets, Venclyxto 100 mg film-coated tablets, Venclyxto 10 mg film-coated tablets

Primary endpoint: Percentage of patients treated with venetoclax + rituximab (VR) achieving uMRD status, i.e. MRD values <10-4 determined by flow cytometry
Endpoint(s): Percentage of patients achieving ORR, PR, CR and Cri, uMRD, treated according to the VR regimen in the Ministry of Health drug program, taking into account pharmacoeconomic and systemic parameters including the number of days of hospitalization and visits during 24 months, Percentage of patients achieving ORR, PR, CR and Cri, uMRD with negative prognostic factors: TP53 deletion/mutation, unmutated IGHV gene and high CD38 expression, Occurrence and correlation with treatment outcomes of potential biomarkers, including cytogenetic abnormalities detected by FISH, mutational status of the IGVH gene and TP53 mutations assessed by Sanger or next-generation sequencing (NGS), in patients treated according to the VR regimen, Results of the QLQ-C30 (EORTC QLQ-C30) questionnaires assessing quality of life (QoL), completed by patients before and during treatment, Number of days of hospitalization in each of the studied regimens, taking into account the period related to venetoclax titration

Source: https://euclinicaltrials.eu/ctis-public/view/2025-524795-35-00